EU clinical trial 2024-519870-38-00: A single arm, multicenter, open-label extension (OLE) trial to evaluate long-term safety and tolerability of pelacarsen (TQJ230) in participants who completed the parent Lp(a)HORIZON trial
Protocol code: CTQJ230A12301E1
Sponsor: Novartis Pharma AG (Pharmaceutical company). Phase: Therapeutic confirmatory (Phase III). Countries: Belgium (ongoing, recruiting), Slovenia (ongoing, recruiting), Spain (ongoing, recruiting), Hungary (ongoing, recruiting), France (ongoing, recruiting), Poland (ongoing, recruiting), Sweden (ongoing, recruiting), Slovakia (ongoing, recruiting), Germany (ongoing, recruiting), Denmark (ongoing, recruiting), Iceland (ongoing, recruiting), Greece (ongoing, recruiting), Austria (ongoing, recruiting), Romania (ongoing, recruiting), Netherlands (ongoing, recruiting), Czechia (ongoing, recruiting), Norway (ongoing, recruiting), Bulgaria (ongoing, recruiting), Portugal (ongoing, recruitment ended), Italy (ongoing, recruiting).
Therapeutic area(s): Diseases [C] - Cardiovascular Diseases [C14]
Gender: Female, Male. Age: 18-64 years, 65+ years. Enrolment: 2906.
Start date (EU): 2026-05-11. Decision date: 2025-08-18. Results received: No. Last updated: 2026-08-03.
Decision dates by country: IS: 2025-08-25, PT: 2025-08-19, SE: 2025-08-25, NO: 2025-08-21, AT: 2025-08-22, BE: 2025-08-19, FR: 2025-08-19, IT: 2025-08-19, RO: 2025-08-25, SI: 2025-08-20, BG: 2025-08-21, HU: 2025-08-22, GR: 2025-08-20, CZ: 2025-08-19, SK: 2025-08-21, DK: 2025-08-18, PL: 2025-08-22, DE: 2025-08-18, ES: 2025-08-21, NL: 2025-08-18

Condition(s): Atherosclerotic cardiovascular disease (ASCVD)
Product: TQJ230

Primary endpoint: ● Occurrence of the followings: • Treatment Emergent Adverse Events (TEAEs) • Treatment Emergent Serious Adverse Events (TESAEs) • Treatment discontinuations due to TEAEs/TESAEs, ● TEAEs of special interest Observed value or change/shift from baseline in: • Safety laboratory measures • Vital signs
Endpoint(s): Time to the first occurrence of 4P-MACE from parent study baseline, Time to the first occurrence of 4P-MACE from OLE study baseline, Cumulative number of 4P-MACE over time from parent study baseline, Cumulative number of 4P-MACE over time from OLE study baseline, Observed value and change in Lp(a) from the parent study baseline, Observed value and change in Lp(a) from the OLE study baseline

Source: https://euclinicaltrials.eu/ctis-public/view/2024-519870-38-00